EU clinical trial 2025-520671-38-00: Clinical trial on the assessment of mucosal visualization quality and diagnostic performance in small bowel capsule endoscopy using different preparation protocols
Sponsor: Hospital Universitario La Paz (Hospital/Clinic/Other health care facility). Phase: Phase III and phase IV (Integrated). Countries: Spain (authorised, recruitment pending).
Therapeutic area(s): Diseases [C] - Digestive System Diseases [C06]
Gender: Female, Male. Age: 18-64 years, 65+ years. Enrolment: 156.
Status: Authorised, recruitment pending. Decision date: 2025-01-21. Results received: No. Last updated: 2025-01-21.

Condition(s): Comparison of diagnostic tools
Product: MOVIPREP, Aero-red 100 mg/ml gotas orales en solución

Primary endpoint: Degree of small bowel cleansing using an accepted cleansing scale.
Endpoint(s): Diagnostic yield of capsule endoscopy defined as: finding of clinically significant lesions., Gastric transit time (GTT): Defined as the time elapsed from the first gastric image to the first duodenal image. This value will be expressed in minutes., Small bowel transit time (STT): This is defined as the time elapsed from the first duodenal image to the first cecal image. When the study does not reach the cecum, the last image of the study will be considered as the first cecal image and it will be indicated that the cecum has not been reached. This value will be expressed in minutes., Tolerability of the preparation: Expresses the degree of acceptance or non-acceptance by the patient of the preparation. For this purpose, a questionnaire will be used, which is not validated, and will be completed at the time the capsule is administered., Percentage of complete studies: A study is considered complete when it has reached the blind spot during the recording time., Other variables: Demographic variables: age, gender, personal history. Reason for requesting capsule endoscopy and diagnosis found. Previous treatment with antiplatelet agents, anticoagulants, non-steroidal anti-inflammatory drugs and/or prokinetics.

Source: https://euclinicaltrials.eu/ctis-public/view/2025-520671-38-00